EU clinical trial 2024-511705-31-00: A Greek multicenter, single-arm, low-intervention clinical trial to evaluate the efficacy and safety of irbesartan/amlodipine fixed combination in newly diagnosed patients or patients with uncontrolled arterial hypertension.
Protocol code: AMIR-FDC
Sponsor: Win Medica Pharmaceutical S.A. (Pharmaceutical company). Phase: Therapeutic confirmatory (Phase III). Countries: Greece (ended).
Therapeutic area(s): Diseases [C] - Cardiovascular Diseases [C14]
Gender: Female, Male. Age: 18-64 years, 65+ years. Enrolment: 346.
Status: Ended. Start date (EU): 2024-09-26. End date (EU): 2026-07-28. Decision date: 2024-06-10. Results received: No. Last updated: 2025-12-08.

Condition(s): Arterial Hypertension
Product: Combipress 150 mg/5 mg επικαλυμμένα με λεπτό υμένιο δισκία, Combipress 150 mg/10 mg επικαλυμμένα με λεπτό υμένιο δισκία, Combipress 300 mg/10 mg επικαλυμμένα με λεπτό υμένιο δισκία, Combipress 300 mg/5 mg επικαλυμμένα με λεπτό υμένιο δισκία

Primary endpoint: Efficacy: Estimation of the percentage of patients who achieved the target SBP, according to the ESC/ESH guidelines for hypertension (2023) and based on Investigator’s judgment, at the following time points from the start of the intervention: 8- 10 weeks and 16 weeks., Safety: Assessment of adverse events (treatment-related AEs leading to temporary or permanent discontinuation of study drug administration, clinically significant AEs, and SAEs regardless of causality), within 16 weeks from the start of the intervention or until the start of a new antihypertensive lawsuit (whichever occurs first)., Patient compliance
Endpoint(s): Percentage of patients who needed the addition of a 3rd drug for controlling their BP during the follow-up period (16 weeks)., Correlation of study drug efficacy with the patient-reported, average value of home blood pressure monitoring (HBPM).

Source: https://euclinicaltrials.eu/ctis-public/view/2024-511705-31-00